EU clinical trial 2023-505458-16-00: A Phase 1b/3 Study of Bemarituzumab Plus Chemotherapy and Nivolumab Versus Chemotherapy and Nivolumab Alone in Subjects With Previously Untreated Advanced Gastric and Gastroesophageal Junction Cancer With FGFR2b Overexpression (FORTITUDE-102)
Protocol code: 20210098
Sponsor: Amgen Inc. (Pharmaceutical company). Phase: Therapeutic confirmatory (Phase III). Countries: Germany (ended), Poland (ended), Austria (ended), Czechia (ended), Portugal (ended), Spain (ended), Bulgaria (ended), France (ended), Romania (ended), Belgium (ended), Italy (ended), Hungary (ended).
Therapeutic area(s): Diseases [C] - Neoplasms [C04]
Gender: Female, Male. Age: 18-64 years, 65+ years. Enrolment: 186.
Status: Ended. Start date (EU): 2022-09-13. End date (EU): 2025-10-29. End date: 2025-10-30. Decision date: 2024-02-20. Results received: No. Last updated: 2025-10-21.
Decision dates by country: BG: 2024-03-22, CZ: 2024-06-11, PL: 2024-02-29, AT: 2024-02-26, RO: 2024-06-17, DE: 2024-02-20, ES: 2024-02-26, FR: 2024-02-23, HU: 2024-06-17, IT: 2024-06-11, BE: 2024-06-12, PT: 2024-02-21

Condition(s): Gastric and Gastroesophageal Junction Cancer With FGFR2b Overexpression
Product: NIVOLUMAB, Bemarituzumab, OXALIPLATIN, FOLINIC ACID, Placebo for AMG 552, CAPECITABINE, FLUOROURACIL

Primary endpoint: Phase 1b: Dose limiting toxicities (DLTs), treatment-emergent adverse events, treatment-related adverse events, and clinically significant changes in vital signs, visual acuity, physical examinations, and clinical laboratory tests, Phase 3: OS, defined as time from randomization until death from any cause. Subjects still alive will be censored at the date last known to be alive
Endpoint(s): Phase 1b: - Objective response [defined as complete response (CR) + partial response (PR)] (as determined by investigator per Response Evaluation Criteria in Solid Tumors version 1.1 [RECIST v1.1])., Phase 1b: - Duration of response (DOR) defined as the time from first response to disease progression (as determined by investigator per RECIST v1.1) or death from any cause, whichever comes first. Only subjects who have achieved objective response will b, Phase 1b: - Disease control rate (DCR) defined as CR + PR + stable disease (SD), Phase 1b: -(PFS) defined as time from first dose of investigational product until the first documentation of radiologic disease progression (by investigator per RECIST v1.1) or death from any cause, whichever occurs first in the, Phase 1b: - Overall survival (OS), defined as time from first dose of investigational product until death from any cause. Subjects still alive will be censored at the date last known to be alive, Phase 1b: PK parameters for bemarituzumab, including, but not limited to, area under the concentration time curve (AUC), maximum observed concentration (Cmax), observed concentration at the end of a dose interval (Ctrough), Phase 1b: Anti-bemarituzumab antibody formation, Phase 3: Progression-free survival, defined as time from randomization until the first documentation of radiologic disease progression or death from any cause, whichever occurs first in the absence of subsequent anticancer therapy. Progression-free surviv, Phase 3: - OS in all randomized subjects. - PFS in all randomized subjects, Phase 3: - Treatment-emergent adverse events (including all adverse events, grade ≥ 3, serious adverse events, fatal adverse events, and adverse events requiring permanent discontinuation of investigational product) - Clinically significant changes in vital signs, visual acuity, and clinical laboratory tests, Phase 3: -Objective response, defined as best overall response (BOR) of CR or PR (as determined by investigator per RECIST v1.1)., - Disease control defined as CR + PR + stable disease (SD)., Phase 3: - Subjective score and change from baseline in following assessments: - EORTC Quality of Life Questionnaire Version 3.0 (QLQ-C30) individual scores (raw and transformed) for the 5 functional scales, 9 symptom scales, global health status/quality, - Summary scores at each assessment and changes from baseline of visual analogue scale (VAS) scores as measured by EuroQol 5-dimensional (EQ-5D-5L) - Time to deterioration in stomach-cancer related symptoms scores - Time to deterioration in health-related, Phase 3: PK parameters for bemarituzumab, including, but not limited to, area under the concentration time curve (AUC), maximum observed concentration (Cmax), observed concentration at the end of a dose interval (Ctrough), Phase 3: Anti-bemarituzumab antibody formation, Phase 3: - Duration of response DOR is defined as the time from the first documentation of objective response (as determined by investigator per RECIST v1.1) until the first documentation of disease progression or death due to any cause, whichever occurs

Source: https://euclinicaltrials.eu/ctis-public/view/2023-505458-16-00